EU clinical trial 2023-508907-19-00: A 4-Week, Phase II, Multicenter, Randomized, Double-Masked, Vehicle-Controlled, Parallel Group Study With 2 Weeks of Follow-Up to Evaluate Safety and Efficacy of Two Different Dosages of Isocyclosporin A Eye Drop Solution Versus Vehicle in Adult Patients with Atopic Keratoconjunctivitis (AKC).
Protocol code: ICY0123
Sponsor: Dompe' Farmaceutici S.p.A. (Pharmaceutical company). Phase: Therapeutic exploratory (Phase II). Countries: Italy (ended).
Therapeutic area(s): Diseases [C] - Eye Diseases [C11]
Gender: Female, Male. Age: 18-64 years, 65+ years. Enrolment: 69.
Status: Ended. Start date (EU): 2024-05-10. End date (EU): 2024-11-29. Decision date: 2024-03-27. Results received: Yes. Last updated: 2024-11-07.

Condition(s): Atopic keratoconjunctivitis (AKC)
Product: Vehicle (Isocyclosporin A 0 mg/mL, 0%), Isocyclosporin A, TROPICAMIDE, SODIUM CHLORIDE, OXYBUPROCAINE

Primary endpoint: Mean change from baseline to Week 4 in ocular itching score assessed by visual analogue scale (VAS) [Time Frame: week 4].
Endpoint(s): Mean change from baseline in ocular symptoms (itching, tearing, discomfort, mucous discharge, photophobia) composite score (0-15) [Time Frame: week 4, 6]., Mean change from baseline in: - ocular itching evaluated on a 4-point scale(0-3)[Time Frame (TF): week 4, 6] - ocular tearing evaluated on a 4-point scale(0-3)[TF: week 4, 6] - ocular discomfort evaluated on a 4-point scale(0-3)[TF: week 4, 6] - ocular mucous discharge evaluated on a 4-point scale(0-3)[TF: week 4, 6] - photophobia evaluated on a 4-point scale(0-3)[TF: week 4, 6] - ocular itching score assessed by visual analog scale(VAS) [TF: week 2, 6], Mean change from baseline in ocular signs (Bulbar conjunctival hyperemia, upper tarsal conjunctival papillae, punctate keratitis, corneal neovascularization, cicatrizing conjunctivitis, and blepharitis) composite score [Time Frame: week 4,6]. Mean change from baseline in blepharitis evaluated on a 4-point scale (0-3) [Time Frame: week 4, 6], Mean change from baseline of the Quality of Life (QoL) scores assessed by the Standardized Rhinoconjunctivitis Quality of Life Questionnaire (RQLQ-S) Time Frame: week 4]., Mean change from baseline in ocular symptoms and signs composite score (0-33) [Time Frame: week 4, 6]., Mean change of post-instillation comfort score (0-4) [Time Frame: at baseline and week 2]., Mean change from baseline in bulbar conjunctival hyperemia, evaluated on a 4-point scale (0-3) [Time Frame: week 2, 4, 6]., Mean change from baseline in corneal epithelial fluorescein staining (modified Oxford scale) [Time Frame: week 2, 4, 6]., Incidence and frequency of treatment-emergent adverse events (TEAEs) assessed throughout the study. Mean change from baseline in best corrected distance visual acuity (BCDVA) [Time Frame: at week 2, 4, 6]. Mean change from baseline in corneal endothelial cell density in both eyes (only at selected sites that have the required equipment) [Time Frame: at week 6] (for the other part please refer to protocol), Treatment discontinuation rate due to tolerability [Time Frame: at week 4], Descriptive pharmacokinetic (PK) assessment [Time Frame: baseline, at week 2, 4]

Source: https://euclinicaltrials.eu/ctis-public/view/2023-508907-19-00